EU clinical trial 2024-519347-15-00: A phase II randomized trial of Lu-PSMA and Stereotactic Radiotherapy versus Radiotherapy alone for oligometastatic prostate cancer (LUST)
Protocol code: IRST185.09
Sponsor: Istituto Romagnolo Per Lo Studio Dei Tumori Dino Amadori IRST S.r.l. (Hospital/Clinic/Other health care facility). Phase: Therapeutic exploratory (Phase II). Countries: Italy (ongoing, recruiting).
Therapeutic area(s): Diseases [C] - Neoplasms [C04]; Diseases [C] - Male Urogenital Diseases [C12]
Gender: Male. Age: 18-64 years, 65+ years. Enrolment: 70.
Status: Ongoing, recruiting. Start date (EU): 2023-06-27. Decision date: 2025-01-15. Results received: No. Last updated: 2025-07-14.

Condition(s): Oligometastatic prostate carcinoma
Product: 177Lu-PSMA I&T_IRSTIRCCS

Primary endpoint: To determine the proportion of men with oligometastatic hormone sensitive prostate cancer who have PSA progressed after 12 months from randomization to Stereotactic Radiotherapy and Lu-PSMA versus Radiotherapy alone.
Endpoint(s): To assess radiographic progression free survival (PFS) after 12 months, ADT free survival (ADT-FS) and Total progression-free survival (PSA-PFS+rPFS) of Lu-PSMA + Stereotactic Radiotherapy vs Stereotactic Radiotherapy defined as the time interval between the day of randomization and the day of disease progression., To describe the toxicity of Lu-PSMA + Stereotactic Radiotherapy vs Stereotactic Radiotherapy for the population enrolled using Common Terminology Criteria for Adverse Events (CTCAE) version 5.0, To assess overall survival (OS) defined as the time interval between the day of randomization and death or last contact., To assess proportion of subjects with undetectable PSA (<0.2 ng/mL) defined as a PSA level ≤0.20 ng/mL as measured during routine follow-up., To assess quality of life in the Lu-PSMA+ Stereotactic Radiotherapy arm vs Stereotactic Radiotherapy only arm using the Functional Assessment of Cancer Therapy – Prostate (FACT-P version 4) questionnaire.

Source: https://euclinicaltrials.eu/ctis-public/view/2024-519347-15-00